EU clinical trial 2023-510366-28-00: A randomized, double-blind, placebo-controlled, Phase 2 study to assess the efficacy, safety, and pharmacokinetics of FNP-223 (oral formulation) to slow the disease progression of progressive supranuclear palsy (PSP) PROSPER
Protocol code: FNP223-CT-2301
Sponsor: Ferrer Internacional S.A. (Pharmaceutical company). Phase: Therapeutic exploratory (Phase II). Countries: Italy (ongoing, recruitment ended), France (ongoing, recruitment ended), Poland (ongoing, recruitment ended), Germany (ongoing, recruitment ended), Portugal (ongoing, recruitment ended), Spain (ongoing, recruitment ended), Hungary (ongoing, recruitment ended).
Therapeutic area(s): Diseases [C] - Nervous System Diseases [C10]
Gender: Female, Male. Age: 18-64 years, 65+ years. Enrolment: 183.
Status: Ongoing, recruitment ended. Start date (EU): 2024-09-25. Decision date: 2024-09-11. Results received: No. Last updated: 2026-05-05.
Decision dates by country: IT: 2024-09-16, HU: 2024-09-13, PL: 2024-09-16, PT: 2024-09-13, FR: 2024-09-13, DE: 2024-09-13, ES: 2024-09-11

Condition(s): Progressive supranuclear palsy (PSP)
Product: FNP-223, Film coated tabled

Primary endpoint: European regulatory authority (EMA): Change from baseline to Week 52 in the total score of the full 28-item PSPRS outcome., US regulatory authority (FDA): Change from baseline to Week 52 in the total score of the mPSPRS-10 outcome., Safety endpoints: Safety will be assessed over a treatment period of 52 weeks for the incidence of TEAEs and SAEs, including clinically significant changes in vital signs, clinical laboratory evaluations (including hormone markers in male participants), physical examination findings, ECG parameters, and suicidal ideation/behavior (Columbia Suicide Severity Rating Scale [C SSRS]).
Endpoint(s): Change from baseline to Week 52 in Clinician Global Impression of Severity scale (CGI-S)., Change from baseline to Week 52 in Patient Global Impression of Severity Scale (PGI-S)., Change from baseline to Week 52 in Caregiver Global Impression of Severity scale (CaGI-S)., Slope of decline in PSPRS., Change from baseline to Week 52 in individual subitems of PSPRS., Change from baseline to Week 52 in Schwab and England Activities of Daily Living Scale (SE-ADL)., Change from baseline to Week 52 in Progressive Supranuclear Palsy Clinical Deficits Scale (PSP-CDS)., Change from baseline to Week 52 in Montreal Cognitive Assessment (MoCA)., Change from baseline to Week 52 in Progressive Supranuclear Palsy Quality of Life scale (PSP-QoL)., PK characterization of FNP-223 and active metabolite.

Source: https://euclinicaltrials.eu/ctis-public/view/2023-510366-28-00